EU clinical trial 2023-503288-40-00: A Randomized, Double-Blind Study Evaluating the Efficacy, Safety, and Immunogenicity of ABP 206 Compared with OPDIVO® (Nivolumab) in Subjects with Treatment-Naïve Unresectable or Metastatic Melanoma
Protocol code: 20210031
Sponsor: Amgen Inc. (Pharmaceutical company). Phase: Therapeutic confirmatory (Phase III). Countries: Germany (ongoing, recruitment ended), Lithuania (ongoing, recruitment ended), Spain (ongoing, recruitment ended), Estonia (ended), Italy (ongoing, recruitment ended), France (ended), Czechia (ongoing, recruitment ended), Portugal (ongoing, recruitment ended), Romania (ongoing, recruitment ended), Netherlands (ended), Croatia (ended), Hungary (ended).
Therapeutic area(s): Diseases [C] - Neoplasms [C04]
Gender: Female, Male. Age: 18-64 years, 65+ years. Enrolment: 396.
Start date (EU): 2024-01-26. Decision date: 2023-08-23. Results received: No. Last updated: 2026-03-23.
Decision dates by country: PT: 2023-11-28, DE: 2023-08-23, RO: 2024-05-13, ES: 2023-08-28, LT: 2023-08-23, NL: 2023-12-04, FR: 2023-09-29, CZ: 2023-11-16, HR: 2023-12-04, HU: 2023-11-28, EE: 2023-08-28, IT: 2023-11-27

Condition(s): Unresectable or Metastatic Melanoma
Product: OPDIVO 10 mg/mL concentrate for solution for infusion., ABP 206

Primary endpoint: Objective response by week 49
Endpoint(s): Secondary Efficacy Endpoints: • Objective response at week 17 • PFS • OS • DOR, Secondary Endpoints Safety-related Endpoints: • Treatment-emergent adverse events • Treatment-emergent serious adverse events • Treatment-emergent adverse events of interest, Secondary Endpoints Immunogenicity-related Endpoints: • Incidence of ADAs, Secondary Endpoints Pharmacokinetic-related Endpoints: • ABP 206 and nivolumab serum (trough) concentrations

Source: https://euclinicaltrials.eu/ctis-public/view/2023-503288-40-00